EU clinical trial 2023-505268-12-00: A Phase III, multicentre, randomised, double-blind, controlled study to investigate the efficacy, safety, and tolerability of two initial administrations of COMP360 in participants with treatment-resistant depression
Protocol code: COMP 006
Sponsor: Compass Pathfinder Limited (Pharmaceutical company). Phase: Therapeutic confirmatory (Phase III). Countries: France (ongoing, recruitment ended), Denmark (ongoing, recruitment ended), Sweden (ongoing, recruitment ended), Germany (ongoing, recruitment ended), Ireland (ongoing, recruitment ended), Netherlands (ongoing, recruitment ended), Spain (ongoing, recruitment ended), Czechia (ongoing, recruitment ended), Poland (ongoing, recruitment ended).
Therapeutic area(s): Psychiatry and Psychology [F] - Mental Disorders [F03]
Gender: Female, Male. Age: 18-64 years, 65+ years. Enrolment: 126.
Status: Ongoing, recruitment ended. Start date (EU): 2024-02-09. Decision date: 2023-10-09. Results received: No. Last updated: 2026-06-29.
Decision dates by country: NL: 2024-06-24, SE: 2023-10-11, DK: 2024-07-22, DE: 2024-07-05, PL: 2024-07-23, IE: 2023-10-13, CZ: 2024-07-25, ES: 2023-10-16, FR: 2023-10-09

Condition(s): Treatment-resistant depression
Product: Psilocybin, Psilocybin, Psilocybin

Primary endpoint: COMP360 25 mg versus COMP360 1 mg for the change from baseline in MADRS total score at Week 6

Source: https://euclinicaltrials.eu/ctis-public/view/2023-505268-12-00